EU clinical trial 2025-524277-16-00: A Phase 1 Study of Fentanyl Vaccine
Sponsor: ARMR Sciences Inc. (Pharmaceutical company). Phase: Phase I and Phase II (Integrated)- First administration to humans. Countries: Netherlands (ongoing, recruiting).
Therapeutic area(s): Health Care [N] - Environment and Public Health [N06]
Gender: Female, Male. Age: 18-64 years. Enrolment: 130.
Status: Ongoing, recruiting. Start date (EU): 2026-02-26. Decision date: 2026-02-23. Results received: No. Last updated: 2026-06-30.

Condition(s): Opioid induced respiratory depression

Source: https://euclinicaltrials.eu/ctis-public/view/2025-524277-16-00